EU clinical trial 2024-516630-35-01: A MULTICENTER, RANDOMIZED, OPEN LABEL PHASE II STUDY OF CARFILZOMIB, CYCLOPHOSPHAMIDE AND DEXAMETHASONE (CCyd) as pre transplant INDUCTION and post transplant consolidation or CARFILZOMIB, LENALIDOMIDE AND DEXAMETHASONE (CRd) as pre transplant INDUCTION and post transplant consolidation or continuous treatment with CARFILZOMIB, LENALIDOMIDE AND DEXAMETHASONE (12 cycles) without transplant, all followed by MAINTENANCE with LENALIDOMIDE (R) versus LENALIDOMIDE AND CARFILZOMIB (CR) IN NEWLY DIAGNOSED MULTIPLE MYELOMA (MM) PATIENTS ELEGIBLE FOR AUTOLOGOUS TRANSPLANT
Protocol code: 2024-516630-35-00
Sponsor: Universita' Degli Studi Di Torino (Educational Institution). Phase: Therapeutic exploratory (Phase II). Countries: Italy (ended).
Therapeutic area(s): Diseases [C] - Neoplasms [C04]
Gender: Female, Male. Age: 18-64 years, 65+ years. Enrolment: 477.
Status: Ended. Start date (EU): 2015-01-12. End date (EU): 2026-03-30. Decision date: 2025-01-21. Results received: No. Last updated: 2025-09-25.

Condition(s): NEWLY DIAGNOSED MULTIPLE MYELOMA (MM) PATIENTS ELEGIBLE FOR AUTOLOGOUS TRANSPLANT
Product: Revlimid 25 mg hard capsules, Revlimid 5 mg hard capsules, Revlimid 10 mg hard capsules, Kyprolis 60 mg powder for solution for infusion, Revlimid 2.5 mg hard capsules

Primary endpoint: All patients will be included in the Intent-to-Treat (ITT) analysis. Efficacy will be assessed by considering VGPR or better (VGPR, sCR and CR) at cycle 4 in the 3 arms. Assessment of VGPR rate will be performed according to the criteria of the International Myeloma Working Group (Appendix D). To determine the progression-free survival in the 2 maintenance arms.
Endpoint(s): To determine the stringent complete response (sCR) rate in the 3 arms after complete induction/consolidation therapy (induction, ASCT and consolidation for the transplant arms and after 12 cycles in the long treatment arm) To determine the progression-free survival in in the 3 induction/consolidation arms.

Source: https://euclinicaltrials.eu/ctis-public/view/2024-516630-35-01